EU clinical trial 2025-522389-66-00: Research into new test methods to measure pain with two existing drugs (nefopam and oxycodone)
Protocol code: CHDR2501
Sponsor: Centre for Human Drug Research (Laboratory/Research/Testing facility). Phase: Human Pharmacology (Phase I)- Other. Countries: Netherlands (ended).
Therapeutic area(s): Diseases [C] - Nervous System Diseases [C10]
Gender: Female, Male. Age: 18-64 years, 65+ years. Enrolment: 24.
Status: Ended. Start date (EU): 2025-09-24. End date (EU): 2026-03-13. Decision date: 2025-09-22. Results received: No. Last updated: 2025-09-22.

Condition(s): (Chronic) pain

Source: https://euclinicaltrials.eu/ctis-public/view/2025-522389-66-00